EU clinical trial 2024-512834-14-00: A Phase II single-arm study of pembrolizumab plus lenvatinib in previously treated classic Kaposi sarcoma (CKS)
Protocol code: MK-3475-B60
Sponsor: Fondazione IRCCS Ca Granda Ospedale Maggiore Policlinico (Hospital/Clinic/Other health care facility). Phase: Therapeutic exploratory (Phase II). Countries: Italy (ended).
Therapeutic area(s): Diseases [C] - Skin and Connective Tissue Diseases [C17]
Gender: Female, Male. Age: 18-64 years, 65+ years. Enrolment: 25.
Status: Ended. End date (EU): 2025-10-15. Decision date: 2024-12-02. Results received: No. Last updated: 2024-12-02.

Condition(s): Advanced unresectable classic Kaposi sarcoma relapsed and/or refractory to previous standard treatments.
Product: Lenvatinib, Lenvatinib, KEYTRUDA 25 mg/mL concentrate for solution for infusion

Primary endpoint: The primary endpoint of the study is to estimate the overall response rate (ORR) during treatment with pembrolizumab and lenvatinib in patients with previously treated relapsed/refractory classic Kaposi sarcoma.
Endpoint(s): To estimate the duration of response (DOR) in patients with pre-treated recurrent CKS receiving pembrolizumab with lenvatinib, to estimate the progression free survival (PFS);, to estimate the overall survival (OS);, to estimate the mean change from baseline in the global health status/quality of life (QoL), and physical functioning for the combinations of pembrolizumab and lenvatinib;, to estimate the safety and tolerability for the combination of pembrolizumab and lenvatinib, to evaluate changes in plasma levels of HHV8 DNA at baseline and at the time of treatment discontinuation, due to any cause (i.e. disease progression, complete response, unacceptable treatment related toxicity), to evaluate changes in plasma levels of circulating markers (i.e. PD-1/PD-L1, VEGF, VEGF-R) at baseline and at the time of treatment discontinuation, due to any cause (i.e. disease progression, complete response, unacceptable treatment related toxicity), to analyze PD-L1 and VEGF expression, and tumor infiltrating lymphocytes in tumor specimens at baseline and at the time of disease progression (optional)

Source: https://euclinicaltrials.eu/ctis-public/view/2024-512834-14-00